EU clinical trial 2024-516894-57-00: A Phase 1/2/3 Study of the Safety and Efficacy of a Single Dose of Autologous CRISPR-Cas9 Modified CD34+ Human Hematopoietic Stem and Progenitor Cells (hHSPCs) in subjects with Transfusion-Dependent β-Thalassemia
Protocol code: CTX001-111
Sponsor: Vertex Pharmaceuticals Inc. (Pharmaceutical company). Phase: Therapeutic confirmatory (Phase III). Countries: Germany (ended).
Therapeutic area(s): Diseases [C] - Congenital, Hereditary, and Neonatal Diseases and Abnormalities [C16]
Gender: Female, Male. Age: 0-17 years, 18-64 years. Enrolment: 5.
Status: Ended. Start date (EU): 2018-09-07. End date (EU): 2025-10-10. End date: 2025-11-13. Decision date: 2024-09-13. Results received: Yes. Last updated: 2025-08-08.

Condition(s): Transfusion-dependent β-thalassemia (TDT)
Product: Casgevy 4 - 13 x 10^6 cells/mL dispersion for infusion, BUSULFAN, FILGRASTIM, PLERIXAFOR

Primary endpoint: Successful neutrophil engraftment, Time to neutrophil engraftment, Time to platelet engraftment, Safety and tolerability assessments based on adverse events (AEs ), clinical laboratory values, and vital signs, Incidence of transplant related mortality (TRM) within 100 days and within 1 year post-CTX001 infusion, All-cause mortality, Proportion of subjects achieving TI12, defined as maintaining weighted average Hb ≥9 g /dL without RBC transfusions for at least 12 consecutive months any time after CTX001 infusion. The evaluation of TI12 starts 60 days after last RBC transfusion for post-transplant support or TDT disease management.
Endpoint(s): Proportion of subjects achieving TI6, defined as maintaining weighted average Hb ≥9 g /dL without RBC transfusions for at least 6 consecutive months any time after CTX001 infusion. The evaluation of TI6 starts 60 days after last RBC transfusion for post-transplant support or TDT disease management., Proportion of subjects achieving at least 95%, 90%, 85%, 75%, 50% reduction from baseline in annualized transfusions up to 24 months starting 60 days after CTX001 infusion., Relative change from baseline in transfusions up to 24 months starting 60 days after CTX001 infusion, Duration of transfusion free in subjects who have achieved TI12, Proportion of alleles with intended genetic modification present in peripheral blood leukocytes over time. Intended genetic modifications are indels that modify the sequence of the erythrocyte-specific enhancer in intron 2 of BCL11A, Proportion of alleles with intended genetic modification present in CD34+ cells of the bone marrow over time, Fetal hemoglobin concentration (pre-transfusion) over time, Total hemoglobin concentration (pre-transfusion) over time, Change in patient reported outcomes (PROs) over time using EuroQol Quality of Life Scale (EQ-5D-5L for subjects ≥18 years old, EQ-5D-Y for subjects <18 years old), functional assessment of cancer therapy-bone marrow transplant (FACT-BMT) for subjects ≥18 years old, and Pediatric Quality of Life Inventory (PedsQL) for subjects <18 years old., Change in parameters of iron overload, including: o Liver iron concentration (LIC ) from baseline as assessed by R2 magnetic resonance imaging (MRI ) and cardiac iron content (CIC ) from baseline as assessed by T2 * MRI o Change in serum ferritin level from baseline over time, Proportion of subjects receiving iron chelation therapy over time

Source: https://euclinicaltrials.eu/ctis-public/view/2024-516894-57-00